EU clinical trial 2023-509657-31-00: A Randomized, Open-Label, C5 Inhibitor-Controlled Study to Evaluate the Efficacy and Safety of Pozelimab and Cemdisiran Combination Therapy in Patients with Paroxysmal Nocturnal Hemoglobinuria who are Complement Inhibitor Treatment-Naive or Have Not Recently Received Complement Inhibitor Therapy
Protocol code: R3918-PNH-2021
Sponsor: Regeneron Pharmaceuticals Inc. (Pharmaceutical company). Phase: Therapeutic confirmatory (Phase III). Countries: Romania (ended), Italy (ended), Poland (ongoing, recruitment ended), Spain (ended), Hungary (ended), Greece (ended).
Therapeutic area(s): Diseases [C] - Hemic and Lymphatic Diseases [C15]
Gender: Female, Male. Age: 18-64 years, 65+ years. Enrolment: 17.
Start date (EU): 2022-08-24. Decision date: 2024-12-12. Results received: No. Last updated: 2026-05-27.
Decision dates by country: ES: 2024-12-12, GR: 2025-01-28, PL: 2024-12-23, HU: 2024-12-17, RO: 2024-12-16, IT: 2025-01-14

Condition(s): Paroxysmal nocturnal haemoglobinuria (PNH)
Product: Soliris 300 mg concentrate for solution for infusion, Pozelimab, Cemdisiran, Ultomiris 300 mg/3 mL concentrate for solution for infusion

Primary endpoint: Cohort A: Percent change in lactate dehydrogenase (LDH), Cohort B: Adequate control of hemolysis (defined as LDH ≤1.5 × ULN) at each visit, Cohort B: Transfusion avoidance (not requiring a red blood cell (RBC) transfusion per the protocol)
Endpoint(s): Maintenance of adequate control of hemolysis (defined as LDH ≤1.5 × ULN) (Cohort A and B), Breakthrough hemolysis (defined as LDH ≥2 × ULN per the protocol) (Cohort A and B), Adequate control of hemolysis (defined as LDH ≤1.5 × ULN) (Cohort A), Hemoglobin stabilization (defined as patients who do not receive an RBC transfusion and have no decrease in hemoglobin level per the protocol) (Cohort A and B), Normalization of LDH (defined as LDH ≤1.0 × ULN per the protocol) (Cohort A and B), Transfusion Avoidance (defined as Not requiring an RBC transfusion as per protocol algorithm based on post-baseline hemoglobin values) (Cohort A), Change in fatigue as measured by the Functional Assessment of Chronic Illness Therapy-Fatigue (FACIT)-Fatigue Scale (Cohort A and B), Change in physical function (PF) scores on the European Organisation for Research and Treatment of Cancer Quality of Life Questionnaire (EORTC-QLQ-C30) (Cohort A and B), Change in global health status (GHS)/QoL scale score on the EORTC-QLC- C30 (Cohort A and B), Percent change in LDH (Cohort B), Rate of RBC transfused per protocol algorithm (Cohort A and B), Number of units of RBC transfused per protocol algorithm (Cohort A and B), Time to first LDH ≤1.5 × ULN (Cohort A and B), Time to first LDH ≤1.0 × ULN (Cohort A and B), Percentage of days with LDH ≤1.5 × ULN (Cohort A and B), Change in hemoglobin levels (Cohort A and B), Incidence and severity of treatment emergent serious adverse events (SAEs) (Cohort A and B), Incidence and severity of treatment-emergent adverse events (TEAEs) of special interest (Cohort A and B), Incidence and severity of TEAEs leading to treatment discontinuation (Cohort A and B), Change in total CH50 (Cohort A and B), Percent change in total CH50 (Cohort A and B), Concentration of total C5 in plasma (Cohort A and B), Concentrations of total pozelimab in serum (Cohort A and B), Concentrations of cemdisiran in plasma (Cohort A and B), Concentrations of total ravulizumab (Cohort A) and total eculizumab (Cohort B) in serum, Incidence of treatment emergent anti-drug antibodies (ADAs) to pozelimab (Cohort A and B), Incidence of treatment emergent ADAs to cemdisiran (Cohort A and B)

Source: https://euclinicaltrials.eu/ctis-public/view/2023-509657-31-00